EU clinical trial 2023-508956-20-00: A Multicenter, Double-blind, Randomized Withdrawal extension study of subcutaneous secukinumab to demonstrate long-term efficacy, safety and tolerability in subjects with moderate to severe hidradenitis suppurativa
Protocol code: CAIN457M2301E1
Sponsor: Novartis Pharma AG (Pharmaceutical company). Phase: Therapeutic confirmatory (Phase III). Countries: Austria (ended), Croatia (ended), Czechia (ended), Portugal (ended), Slovakia (ended), Poland (ended), Belgium (ended), Hungary (ended), Italy (ended), Lithuania (ended), Netherlands (ended), Bulgaria (ended), Spain (ended), Greece (ended).
Therapeutic area(s): Diseases [C] - Skin and Connective Tissue Diseases [C17]
Gender: Female, Male. Age: 18-64 years, 65+ years. Enrolment: 197.
Status: Ended. Start date (EU): 2020-03-12. End date (EU): 2026-06-03. End date: 2026-07-15. Decision date: 2024-08-06. Results received: No. Last updated: 2026-04-10.
Decision dates by country: AT: 2024-08-12, BE: 2024-08-07, HR: 2024-08-13, GR: 2024-09-20, HU: 2024-08-06, ES: 2024-08-07, NL: 2024-08-06, PL: 2024-08-07, CZ: 2024-08-07, IT: 2024-08-12, LT: 2024-08-13, PT: 2024-08-07, BG: 2024-08-08, SK: 2024-08-08

Condition(s): Hidradenitis suppurativa
Product: Placebo to AIN457 300mg/2mL Solution for injection in pre-filled syringe, SECUKINUMAB

Primary endpoint: Time to loss of response up to Week 104 (Randomized Withdrawal period) in subjects who were HiSCR responders at Week 52 in the core studies. HiSCR response is defined as at least 50% decrease in Abscess and inflammatory Nodule (AN) number relative to the Baseline visit in the core study, with no increase in the number of abscesses and in the number of draining fistulae. Loss of response is defined as: • at least a 50% or greater increase in AN count (abscess and/or nodules) at a regular or unsch
Endpoint(s): Adverse events, laboratory values, vital signs

Source: https://euclinicaltrials.eu/ctis-public/view/2023-508956-20-00